EU clinical trial 2024-510714-32-00: GYNET : A randomized, multicenter, open label, Phase I/II study to evaluate the safety (Phase I - safety run in), clinical and biological activity (Phase II) of a humanized monoclonal antibody targeting Netrin-1 (NP137) in combination with carboplatin plus paclitaxel and/or pembrolizumab in patients with locally advanced/metastatic endometrial carcinoma or cervix carcinoma progressing/relapsing after at least one prior systemic chemotherapy
Protocol code: ET-20-049
Sponsor: Netris Pharma (Pharmaceutical company). Phase: Therapeutic exploratory (Phase II). Countries: France (ongoing, recruitment ended).
Therapeutic area(s): Diseases [C] - Pathological Conditions, Signs and Symptoms [C23]; Diseases [C] - Neoplasms [C04]
Gender: Female. Age: 18-64 years, 65+ years. Enrolment: 240.
Status: Ongoing, recruitment ended. Start date (EU): 2020-12-10. Decision date: 2024-09-05. Results received: No. Last updated: 2026-07-03.

Condition(s): Patiens with locally advanced/metastatic endometrial carcinoma or cervix carcinoma progressing/relapsing after at least one prior systemic chemotherapy.
Product: NP137, PACLITAXEL, KEYTRUDA 25 mg/mL concentrate for solution for infusion, CARBOPLATIN

Primary endpoint: Phase II part: Overall response Rate (ORR) after 3 months (ORR3m) is defined as the rate of patients with CR or PR. Response will be evaluated as per RECIST 1.1 (Eisenhauer et al., 2009) by BICR after 3 months of treatment.
Endpoint(s): Part II part, both part safety endpoints: Safety will be assessed by the following assessments: adverse events (AEs), vital signs, ECG, physical examination, laboratory safety assessments (hematological and biochemical parameters). All AEs will be graded according to NCI-CTCAE V5.0. In case of Infusion Related Reaction, blood samples will be collected to monitor the PK profile and Immunogenicity using ADA for NP137 assays., Phase II part, both part efficacy endpoints: Objective response Rate (ORR) after 3 months of treatment will be also assessed as per modified criteria for immunotherapies iRECIST. Overall objective response Rate beyond 3 months of treatment will be assessed as per RECIST V1.1 and iRECIST (assessment by both BICR and investigator). Duration of Response (DoR). *Best Overall Response Rate. *Clinical Benefit Rate (CBR). *Progression-free survival (PFS). *Overall survival (OS), Pharmacokinetic endpoints: The following PK parameters will be determined for NP137 treated patients during the safety run in period only: Cmax, tmax, AUCt, AUC, CL, t½ based on both individual PK and popPK models.

Source: https://euclinicaltrials.eu/ctis-public/view/2024-510714-32-00